EU clinical trial 2024-513834-40-01: BIOLOGICAL STANDARDISATION OF ALLERGENIC EXTRACTS OF MITES (Dermatophagoides pteronyssinus, Dermatophagoides farinae, Blomia tropicalis and Lepidoglyphus destructor) TO DETERMINE BIOLOGICAL ACTIVITY IN HISTAMINE EQUIVALENT UNITS (HEP) IN SENSITIVISED PATIENTS.
Protocol code: DIA-STA04080912-0124
Sponsor: Diater Laboratorio De Diagnostico Y Aplicaciones Terapeuticas S.A. (Pharmaceutical company). Phase: Therapeutic exploratory (Phase II). Countries: Spain (ended).
Therapeutic area(s): Analytical, Diagnostic and Therapeutic Techniques and Equipment [E] - Diagnosis [E01]
Gender: Female, Male. Age: 18-64 years. Enrolment: 90.
Status: Ended. Start date (EU): 2024-10-01. End date (EU): 2025-07-23. Decision date: 2024-08-29. Results received: Yes. Last updated: 2026-06-22.

Condition(s): Allergies
Product: Histamine dihydrochloride skin-prick test, Dermatophagoides pteronyssinus skin-prick test, Blomia tropicalis skin-prick test, Dermatophagoides farinae skin-prick test, Lepidoglyphus destructor skin-prick test

Primary endpoint: The area of the wheal (mm2) that occurs at the cutaneous level after the administration of the extracts in the prick test for the calculation of the primary endpoint
Endpoint(s): To determine the in vitro biological potency expressed as HEP (1 HEP = 10,000 biological units) of the concentration of the investigational product that elicits a wheal of a size equivalent to that produced by a solution of histamine dihydrochloride at 10 mg/ml., Safety assessment through descriptive analysis of adverse reactions that may occur during the course of the study.

Source: https://euclinicaltrials.eu/ctis-public/view/2024-513834-40-01